EU clinical trial 2024-516582-36-00: Single arm phase 2 trial of neoadjuvant trastuzumab deruxtecan (T-DXd) with response-directed definitive therapy in early stage HER2-positive breast cancer: a standard chemotherapy-sparing approach to curative-intent treatment – SHAMROCK study
Protocol code: CTRIAL‐IE-22‐01
Sponsor: Cancer Trials Ireland (Patient organisation/association). Phase: Phase II and Phase III (Integrated). Countries: Ireland (ongoing, recruiting).
Therapeutic area(s): Diseases [C] - Neoplasms [C04]
Gender: Female, Male. Age: 18-64 years, 65+ years. Enrolment: 77.
Status: Ongoing, recruiting. Start date (EU): 2026-05-01. Decision date: 2024-09-09. Results received: No. Last updated: 2026-02-04.

Condition(s): Early stage HER2-positive breast cancer
Product: Herceptin 150 mg powder for concentrate for solution for infusion, DS-8201a, Perjeta 420 mg concentrate for solution for infusion, Paclitaxel 6 mg/ml concentrate for solution for infusion

Primary endpoint: The percentage of patients who achieve iCR after 4 cycles of T-DXd treatment and thus avoid standard cytotoxic chemotherapy. Imaging complete response (iCR) is defined as the resolution of all previously described suspicious abnormalities.
Endpoint(s): 3-year EFS and OS of patients treated with only T-DXd and adjuvant trastuzumab. EFS is defined as time from registration to disease recurrence, progression, or death from any cause. OS is defined as the time from registration to date of death from any cause, censored at date last known to be alive for those who have not died., 3-year EFS and OS of patients treated with systemic therapy other than adjuvant trastuzumab in addition to T-DXd., 3-year EFS and OS of the entire study population., 3-year EFS and OS difference between patients achieving vs not achieving pCR at surgery., 3-year EFS and OS difference between patients with high RDI Score vs low/intermediate score., Percentage of patients who achieve iCR after only 4 cycles of T-DXd by RDI Zone (high vs low/intermediate score)., Overall percentage of patients who achieve iCR after any treatment (i.e. either after 4 or 8 cycles of treatment) and by RDI Zone (high vs low/intermediate score)., Percentage of patients who achieve pCR at surgery after 4 cycles of T-DXd and by RDI Score (high vs low/intermediate score)., Overall percentage of patients who achieve pCR at surgery (i.e. either after 4 or 8 cycles of treatment) and by RDI Zone (high vs low/intermediate score)., Molecular evolution of tumours during treatment., The performance metrics (NPV, PPV, sensitivity, specificity) for prediction of non-pCR / pCR of RDI alone, imaging alone and combination of RDI with imaging, To evaluate the safety and tolerability of study treatment T-DXd, and THP as measured by incidence of adverse events reported and toxicity evaluation as per the NCI Common Terminology Criteria for Adverse Events (CTCAE version 5.0)., The composition of the gut microbiome (GM) before and after neoadjuvant treatment and any association between the GM and the pathological response at the time of surgery., The utility of Tumour-Infiltrating Lymphocytes (TILs) as a biomarker of response to T-DXd in early stage HER2-positive breast cancer, The utility of lung specific DNA markers in breath for prediction of the occurrence of pneumonitis.

Source: https://euclinicaltrials.eu/ctis-public/view/2024-516582-36-00